EU clinical trial 2025-523724-47-00: A Randomized Phase 2/3 Study Evaluating the Safety and Efficacy of Pivekimab Sunirine (PVEK) in Combination with Venetoclax and Azacitidine in Adult Subjects with Newly Diagnosed Acute Myeloid Leukemia (AML) Ineligible to Receive Intensive Chemotherapy
Protocol code: M26-092
Sponsor: AbbVie Deutschland GmbH & Co. KG (Pharmaceutical company). Phase: Phase II and Phase III (Integrated). Countries: France (authorised, recruitment pending), Spain (authorised, recruitment pending).
Therapeutic area(s): Diseases [C] - Neoplasms [C04]
Gender: Female, Male. Age: 18-64 years, 65+ years. Enrolment: 18.
Status: Authorised, recruitment pending. Decision date: 2026-08-03. Results received: No. Last updated: 2026-08-05.
Decision dates by country: FR: 2026-08-03, ES: 2026-08-05

Condition(s): Acute Myeloid Leukemia
Product: Venetoclax, PIVEKIMAB SUNIRINE, Venetoclax, AZACITIDINE, Venetoclax

Primary endpoint: Phase 2: Complete remission (CR), Phase 3: Complete remission (CR), Phase 3: Overall Survival (OS), Number of Participants with Adverse Events (AEs)
Endpoint(s): Phase 2 and Phase 3: Composite Response, Phase 2 and Phase 3: Duration of CR (DoCR), Phase 2: Change from baseline in the European Organisation for Research and Treatment of Cancer Quality of Life Questionnaire Core 30 (EORCT QLQ-C30) domains, Phase 3: Percentage of Participants with Transfusion Independence, Phase 3: Conversion from baseline transfusion dependence to post-baseline transfusion independence, Phase 3: Change from baseline in the EORCT QLQ-C30 physical functioning domains, Phase 3: Change from baseline in the remaining EORCT QLQ-C30 domains, Phase 3: Change from Baseline in European Quality of Life 5 Dimensions (EQ-5D-5L) Utility Index and Visual Analog Scale (VAS) scores, Phase 3: Change from Baseline to the responses to FACT GP5

Source: https://euclinicaltrials.eu/ctis-public/view/2025-523724-47-00